EU clinical trial 2025-521098-14-00: J2A-MC-GZPO: A Master Protocol to Investigate the Efficacy and Safety of Orforglipron Tablet Once Daily Compared with Placebo in Participants with Obesity or Overweight with and without Type 2 Diabetes. J2A-MC-GZP1: Participants with obesity or overweight with at least 1 weight-related comorbidity, without type 2 diabetes. J2A-MC-GZP2: Participants with obesity or overweight with type 2 diabetes
Protocol code: J2A-MC-GZPO
Sponsor: Eli Lilly & Co. (Pharmaceutical company). Phase: Therapeutic confirmatory (Phase III). Countries: Czechia (ongoing, recruitment ended), Germany (ongoing, recruitment ended).
Therapeutic area(s): Diseases [C] - Nutritional and Metabolic Diseases [C18]
Gender: Female, Male. Age: 18-64 years. Enrolment: 237.
Status: Ongoing, recruitment ended. Start date (EU): 2025-08-15. Decision date: 2025-07-23. Results received: No. Last updated: 2026-04-16.
Decision dates by country: DE: 2025-07-24, CZ: 2025-07-28

Condition(s): GZP1, GZP2: Obesity, Overweight; GZP2: Type 2 Diabetes
Product: Orforglipron, Placebo to match LY, Orforglipron, Orforglipron, Orforglipron, Orforglipron, Orforglipron

Primary endpoint: (GZPO) Number of Participants Allocated to Each Study [Time Frame: Baseline to Week 4], (GZP1) Percent Change from Baseline in Body Weight [Time Frame: Baseline, Week 40], (GZP2) Change from Baseline in Hemoglobin A1c (HbA1c) [Time Frame: Baseline, Week 40]

Source: https://euclinicaltrials.eu/ctis-public/view/2025-521098-14-00